EU clinical trial 2024-517666-41-00: Short versus long-term androgen deprivation therapy combined with salvage radiotherapy in prostate cancer patients with biochemical recurrence after prostatectomy: a multicentre phase III randomised controlled trial
Protocol code: URONCOR 06-24
Sponsor: Instituto De Investigacion En Oncología Radioterapica FEOR (Laboratory/Research/Testing facility). Phase: Therapeutic confirmatory (Phase III). Countries: Spain (ongoing, recruiting).
Therapeutic area(s): Diseases [C] - Male Urogenital Diseases [C12]; Diseases [C] - Neoplasms [C04]
Gender: Male. Age: 18-64 years. Enrolment: 534.
Status: Ongoing, recruiting. Start date (EU): 2023-03-13. Decision date: 2024-11-08. Results received: No. Last updated: 2026-01-14.

Condition(s): Prostate Cancer
Product: Zoladex 3,6 mg implante en jeringa precargada, Decapeptyl semestral 22,5 mg polvo y disolvente para suspensión de liberación prolongada inyectable., Eligard semestral 45 mg polvo y disolvente para solución inyectable., Bicalutamida Aristo 50 mg comprimidos recubiertos con película EFG

Primary endpoint: Compared to short-term ADT (6 months), long-term ADT (24 months) could improve 5-year distant metastasis-free survival (MFS) in patients with biochemically-recurrent prostate cancer after radical prostatectomy who are candidates for salvage radiotherapy

Source: https://euclinicaltrials.eu/ctis-public/view/2024-517666-41-00